EU clinical trial 2024-514261-19-00: A Phase 1b/2, Safety Lead-in and Dose-Expansion, Open label, Multicenter Trial Investigating the Safety, Tolerability, and Preliminary Activity of Ivosidenib in Combination with Durvalumab and Gemcitabine/Cisplatin as First-line Therapy in Participants with Locally Advanced, Unresectable or Metastatic Cholangiocarcinoma with an IDH1 Mutation
Protocol code: S095031-210
Sponsor: Institut De Recherches Internationales Servier IRIS (Pharmaceutical company). Phase: Phase I and Phase II (Integrated)- Other. Countries: France (temporarily halted), Germany (temporarily halted), Spain (temporarily halted).
Therapeutic area(s): Diseases [C] - Neoplasms [C04]
Gender: Female, Male. Age: 18-64 years, 65+ years. Enrolment: 16.
Status: Temporarily halted. Start date (EU): 2025-03-24. Decision date: 2025-02-19. Results received: No. Last updated: 2026-06-04.
Decision dates by country: ES: 2025-02-19, DE: 2025-02-26, FR: 2025-03-13

Condition(s): Locally advanced, unresectable or metastatic cholangiocarcinoma with an IDH1 mutation
Product: IMFINZI 50 mg/mL concentrate for solution for infusion., Gemcitabin Hikma 38 mg/ml Konzentrat zur Herstellung einer Infusionslösung, Cisplatin Hikma 1 mg/ml Konzentrat zur Herstellung einer Infusionslösung, AG-120/S95031 250mg film-coated tablet

Primary endpoint: Safety Lead-in Phase: Dose-limiting toxicities (DLTs) associated with ivosidenib in combination with durvalumab and gemcitabine/ cisplatin as first-line therapy during the first cycle of treatment, Safety Lead-in Phase: Incidence and severity of adverse events (AEs), adverse events of special interest (AESIs), and serious adverse events (SAEs), Safety Lead-in Phase: Dose reductions, delays, interruptions, and discontinuation., Expansion phase: Objective response (confirmed complete response ([CR] or confirmed partial response [PR]) of anti-tumor activity of ivosidenib in combination with durvalumab and gemcitabine/cisplatin as first-line therapy using RECIST v1.1
Endpoint(s): Safety Lead-in Phase: Ivosidenib plasma concentrations and PK parameters including, but not limited to: • Area under the concentration-versus-time curve (AUC) from time 0 to time of last measurable concentration (AUC0-t) • AUC over 1 dosing interval at steady state (AUCtau,ss) • Time to maximum concentration (Tmax) • Maximum concentration (Cmax) • Trough concentration (Ctrough) • Apparent volume of distribution (Vd/F) • Apparent clearance (CL/F), Safety Lead-in Phase: PD parameters including plasma 2-hydroxygluturate (2-HG) concentrations, Safety Lead-in Phase and Expansion Phase: Presence of ADAs for durvalumab (confirmatory results: positive or negative, titres), Expansion Phase: Incidence and severity of AEs, AESIs, and SAEs, Expansion Phase: Dose reductions, delays, interruptions, and discontinuation, Expansion Phase: Overall survival (OS), Expansion Phase: Duration of response (DOR), progression-free survival (PFS), disease control (i.e., confirmed CR, confirmed PR, or stable disease [SD]), and time to response (TTR) according to RECIST v1.1, Expansion Phase: Ivosidenib plasma concentrations and PK parameters including, but not limited to, AUC0-t, AUCtau,ss, Tmax, Cmax, Ctrough, Vd/F, and CL/F, Expansion Phase: Plasma 2-hydroxygluturate (2-HG) concentration

Source: https://euclinicaltrials.eu/ctis-public/view/2024-514261-19-00